EU clinical trial 2023-504288-18-00: A Phase 1, Double-blind, Randomized, Placebo-controlled, First-in-Human Study of Orally Administered DF-006 to Evaluate the Safety, Tolerability, and Pharmacokinetics After a Single Dose and Multiple Doses of Orally Administered DF-006 in Healthy Subjects (Part 1 and Part 2) and in Chronic Hepatitis B Patients (Part 3). Protocol Number Df-006-1001
Protocol code: DF-006-1001
Sponsor: Zhejiang Yaoyuan Biotechnology Co. Ltd. (Pharmaceutical company). Phase: Human Pharmacology (Phase I)- Other. Countries: Romania (authorised, recruitment pending), Bulgaria (authorised, recruitment pending).
Therapeutic area(s): Diseases [C] - Virus Diseases [C02]
Gender: Female, Male. Age: 18-64 years. Enrolment: 12.
Status: Authorised, recruitment pending. Decision date: 2024-04-16. Results received: No. Last updated: 2024-04-17.
Decision dates by country: BG: 2024-04-17, RO: 2024-04-16

Condition(s): Chronic Hepatitis B

Source: https://euclinicaltrials.eu/ctis-public/view/2023-504288-18-00